EU clinical trial 2024-511612-24-00: A randomized, two-way, crossover, two parallel groups study to compare the bioavailability of 150 mg and 300 mg trazodone hydrochloride tablets (new polymer) (Angelini Pharma S.p.A.) vs. 150 mg and 300 mg trazodone hydrochloride Contramid® tablets (Angelini Pharma S.p.A.) at steady-state
Protocol code: 039(C/a)MD23341
Sponsor: Angelini Pharma Italia Aziende Chimiche Riunite Angelini Francesc O A.C.R.A.F. S.p.A. (Pharmaceutical company). Phase: Human Pharmacology (Phase I)- Bioequivalence Study. Countries: Germany (ended).
Therapeutic area(s): Psychiatry and Psychology [F] - Mental Disorders [F03]
Gender: Female, Male. Age: 18-64 years, 65+ years. Enrolment: 64.
Status: Ended. Start date (EU): 2024-05-31. End date (EU): 2024-08-07. Decision date: 2024-05-22. Results received: No. Last updated: 2024-07-17.

Condition(s): Intended indication: Major Depressive Disorders with and without anxiety, Healthy volunteers, therapeutic indication not studied

Source: https://euclinicaltrials.eu/ctis-public/view/2024-511612-24-00